EU clinical trial 2024-511198-31-00: A Long-Term Follow-Up Study for Participants Previously Treated with KYV-101 (KYSA-4)
Protocol code: KYV101-004
Sponsor: Kyverna Therapeutics Inc. (Pharmaceutical company). Phase: Phase II and Phase III (Integrated). Countries: Germany (ongoing, recruiting).
Therapeutic area(s): Diseases [C] - Immune System Diseases [C20]; Diseases [C] - Musculoskeletal Diseases [C05]
Gender: Female, Male. Age: 18-64 years, 65+ years. Enrolment: 30.
Status: Ongoing, recruiting. Start date (EU): 2026-03-24. Decision date: 2026-03-06. Results received: No. Last updated: 2026-07-31.

Condition(s): Myasthenia Gravis, Stiff Person Syndrome, Lupus Nephritis, Rheumatoid Arthritis, Systemic Sclerosis
Product: KYV-101

Primary endpoint: Incidence of AEs, including the following: - New malignancy (ies) - New incidence or exacerbation of a pre-existing neurologic disorder - New incidence or exarcebation of a prior rheumatologic or other autoimmune disorder - New incidence of a hematologic disorder - New incidence of injection (potentially product-related) - Persistence of KYV-01 as assessed by ddPCR - Incidence of RCL by qPCR

Source: https://euclinicaltrials.eu/ctis-public/view/2024-511198-31-00